EU clinical trial 2024-518511-19-00: A Phase 3, Randomized, Multicenter, Parallel-group, Non-inferiority, Open-label Study Evaluating the Efficacy, Safety, and Tolerability of Cabotegravir Ultra Long-acting Plus Rilpivirine Ultra Long-acting or Cabotegravir Long-acting Plus Rilpivirine Long-acting in Adults and Adolescents with HIV who are Virologically Suppressed on ART
Protocol code: 222794
Sponsor: Viiv Healthcare UK Limited (Pharmaceutical company). Phase: Therapeutic confirmatory (Phase III). Countries: Spain (authorised, recruitment pending).
Therapeutic area(s): Diseases [C] - Immune System Diseases [C20]
Gender: Female, Male. Age: 0-17 years, 18-64 years, 65+ years. Enrolment: 81.
Status: Authorised, recruitment pending. Decision date: 2026-08-05. Results received: No. Last updated: 2026-08-05.

Condition(s): HIV Infections
Product: REKAMBYS 900 mg prolonged-release suspension for injection, JNJ-16150108, Vocabria 600 mg prolonged-release suspension for injection

Primary endpoint: Plasma HIV-1 RNA greater than or equal to 50 copies/mL as per FDA Snapshot algorithm at Month 11 (FAS).
Endpoint(s): 1. Plasma HIV-1 RNA greater than or equal to 50 copies/mL as per FDA Snapshot algorithm at Month 23 FAS., 2. Plasma HIV-1 RNA <50 copies/mL at Month 11 and 23 using the FDA Snapshot algorithm (FAS)., 3. Protocol-defined confirmed virologic failure (CVF, defined as 2 consecutive HIV-1 RNAs >=200 copies/mL) through Months 11 and 23., 4. Grade 2-5 drug-related AEs and SAEs and Treatment discontinuation due to AEs/injection intolerability over time including Months 11 and 23., 5. Treatment emergent genotypic and phenotypic resistance to CAB, RPV through Months 11 and 23., 6. Plasma CAB and RPV concentrations and plasma PK parameters for CAB and RPV (when evaluable, Ctrough, maximum concentrations post dose [~Cmax], and area under the curve [AUC])., 7. Plasma HIV-1-RNA greater than or equal to 50 copies/mL as per FDA Snapshot algorithm at Months 11 and 23 (FAS- adolescents)., 8. Plasma HIV-1 RNA <50 copies/mL at Months 11 and 23 using the FDA Snapshot algorithm (FAS-adolescents)., 9. Protocol-defined confirmed virologic failure (CVF, defined as 2 consecutive HIV-1 RNAs >=200 copies/mL) through Months 11 and 23., 10. Absolute value and change from baseline in CD4+ cell counts over time including Months 11 and 23., 11. Grade 2-5 drug-related AEs and SAEs, and Treatment discontinuation due to AEs/injection intolerability over time including Months 11 and 23.

Source: https://euclinicaltrials.eu/ctis-public/view/2024-518511-19-00